EU clinical trial 2023-507128-22-00: A Phase 2 Randomized, Double-Blind, Placebo-Controlled Study of NIDO-361 in Patients with Spinal and Bulbar Muscular Atrophy (SBMA)
Protocol code: NIDO-361-002
Sponsor: Nido Biosciences Inc. (Pharmaceutical company). Phase: Therapeutic exploratory (Phase II). Countries: Italy (ended), Denmark (ended).
Therapeutic area(s): Diseases [C] - Musculoskeletal Diseases [C05]
Gender: Male. Age: 18-64 years, 65+ years. Enrolment: 27.
Status: Ended. Start date (EU): 2024-03-01. End date (EU): 2025-10-22. Decision date: 2024-01-31. Results received: Yes. Last updated: 2025-09-16.
Decision dates by country: DK: 2024-01-31, IT: 2024-02-05

Condition(s): Spinal and Bulbar Muscular Atrophy
Product: NIDO-361 placebo tablets, NIDO-361

Primary endpoint: 1. Change from baseline in thigh and total lean muscle volume (LMV) as assessed by whole-body MRI., 2. Number of patients with adverse events (AEs) or serious adverse events (SAEs)., 3. Number of patients discontinuing study and number of deaths., 4. Number of mild, moderate, and severe AEs
Endpoint(s): 1. Change from baseline in 6MWT, 2. Change from baseline in modified-SBMAFRS (m-SBMAFRS), 3. Change from baseline in actigraphy-derived physical activity, 4. Change from baseline in timed up and go (TUG) test, 5. Change from baseline in grip strength as measured by handheld dynamometer (HHD), 6. Change from baseline in two-minute walk test (2MWT)

Source: https://euclinicaltrials.eu/ctis-public/view/2023-507128-22-00